EU clinical trial 2025-524061-24-01: Study to compare drug availability in the bloodstream of two oral formulations of dexketoprofen in healthy volunteers under fasting conditions.
Protocol code: 1042/25;DEXO-0125/BE
Sponsor: Faes Farma S.A. (Pharmaceutical company). Phase: Human Pharmacology (Phase I)- Bioequivalence Study. Countries: Czechia (ended).
Therapeutic area(s): Not possible to specify
Gender: Female, Male. Age: 18-64 years. Enrolment: 48.
Status: Ended. Start date (EU): 2026-02-13. End date (EU): 2026-03-04. Decision date: 2026-02-06. Results received: No. Last updated: 2026-02-06.

Condition(s): Bioequivalence clinical trial in healthy volunteers under fasting conditions.

Source: https://euclinicaltrials.eu/ctis-public/view/2025-524061-24-01